EU clinical trial 2023-505005-16-00: A Randomized, Phase 2 Study of Pembrolizumab And Chemotherapy With or Without MK-4830 as Neoadjuvant Treatment for High-Grade Serous Ovarian Cancer
Protocol code: MK-4830-002
Sponsor: Merck Sharp & Dohme LLC (Pharmaceutical company). Phase: Therapeutic exploratory (Phase II). Countries: Italy (ended), Spain (ended), Poland (ended), Belgium (ended).
Therapeutic area(s): Diseases [C] - Neoplasms [C04]
Gender: Female. Age: 18-64 years, 65+ years. Enrolment: 32.
Status: Ended. Start date (EU): 2022-07-27. End date (EU): 2024-10-01. End date: 2024-10-15. Decision date: 2023-12-20. Results received: Yes. Last updated: 2024-09-02.
Decision dates by country: ES: 2023-12-20, PL: 2024-02-05, BE: 2024-04-30, IT: 2024-01-11

Condition(s): Primary peritoneal cancer/Fallopian tube cancer
Product: CARBOPLATIN, BEVACIZUMAB, MK-4830, PACLITAXEL, KEYTRUDA 25 mg/mL concentrate for solution for infusion, DOCETAXEL

Primary endpoint: Change from Baseline in Circulating Tumor Deoxyribonucleic Acid (ctDNA)
Endpoint(s): Change from Baseline in Neoadjuvant ctDNA, Pathological Complete Response (pCR) Rate, Chemotherapy Response Score (CRS), Number of Participants Who Experienced an Adverse Event (AE), Number of Participants Who Discontinued Study Treatment Due to an AE

Source: https://euclinicaltrials.eu/ctis-public/view/2023-505005-16-00